EU clinical trial 2025-520640-15-00: Randomized clinical trial to evaluate the efficacy of fibrin membrane graft with eye drops concentrated in autologous growth factors in primary pterygium surgery compared to amniotic membrane graft in terms of recurrence during the first year after surgery.
Sponsor: Fundacio Institut De Recerca De L'Hospital De La Santa Creu I Sant Pau (Hospital/Clinic/Other health care facility). Phase: Phase III and phase IV (Integrated). Countries: Spain (ongoing, recruiting).
Therapeutic area(s): Diseases [C] - Eye Diseases [C11]; Analytical,Diagnostic,Therapeutic Techniques and Equipment [E]-Surgical Procedures, Operative [E04]
Gender: Female, Male. Age: 18-64 years. Enrolment: 110.
Status: Ongoing, recruiting. Start date (EU): 2025-01-30. Decision date: 2025-01-30. Results received: No. Last updated: 2025-01-30.

Condition(s): pterygium
Product: ENDORET-PRGF

Primary endpoint: Recurrence rate in both techniques. Defined as the number of recurrences per technique divided by the surgeries performed with amniotic membrane implant and those using fibrin-rich growth factor graft. Recurrence is understood as the appearance of fibrovascular proliferation invading the corneal limbus and the cornea. This will be evaluated during follow-up at one month, two months, three months, six months, and one year after the intervention.

Source: https://euclinicaltrials.eu/ctis-public/view/2025-520640-15-00